EU clinical trial 2024-513539-25-00: A Phase 2 Randomized, Double-blind, Placebo‑controlled, Dose‑ranging Study to Evaluate the Efficacy, Safety, and Tolerability of Maridebart Cafraglutide in Adult Subjects With Type 2 Diabetes Mellitus
Protocol code: 20230143
Sponsor: Amgen Inc. (Pharmaceutical company). Phase: Therapeutic exploratory (Phase II). Countries: Austria (ongoing, recruitment ended), Italy (ongoing, recruitment ended), Sweden (ongoing, recruitment ended), Hungary (ongoing, recruitment ended), Romania (ongoing, recruitment ended), Greece (ongoing, recruitment ended), Spain (ongoing, recruitment ended), Poland (ongoing, recruitment ended).
Therapeutic area(s): Diseases [C] - Nutritional and Metabolic Diseases [C18]
Gender: Female, Male. Age: 18-64 years, 65+ years. Enrolment: 219.
Status: Ongoing, recruitment ended. Start date (EU): 2024-11-22. Decision date: 2024-11-08. Results received: No. Last updated: 2026-05-19.
Decision dates by country: AT: 2024-11-13, IT: 2024-11-11, ES: 2024-11-14, SE: 2024-11-12, RO: 2024-11-13, PL: 2024-11-11, HU: 2024-11-13, GR: 2024-11-11

Condition(s): Type 2 Diabetes Mellitus
Product: Placebo for AMG 133, AMG 133

Primary endpoint: Change from baseline to week 24 in hemoglobin A1c (HbA1c)
Endpoint(s): Percent change from baseline to week 24 in body weight, Achieving HbA1c < 7.0% at week 24 Achieving HbA1c ≤ 6.5% at week 24, Achieving ≥ 5% reduction in body weight from baseline at week 24 Achieving ≥ 10% reduction in body weight from baseline at week 24, Change from baseline to week 24 in fasting glucose, Percent changes from baseline to week 24 in total cholesterol, low-density lipoprotein cholesterol (LDL-C), high-density lipoproteincholesterol (HDL-C), non-high density lipoprotein cholesterol (non-HDL-C), very-low-density lipoprotein cholesterol (VLDL-C), triglycerides, and free fatty acids (FFA), Changes from baseline to week 24 in systolic blood pressure (SBP) and diastolic blood pressure (DBP), Plasma maridebart cafraglutide concentrations including observed predose plasma concentration (Cpredose) at week 20 and, if available, maximum observed plasma concentration (Cmax) as defined by week 20 day 5 to 14 postdose sample, Incidence of treatment-emergent adverse events and serious adverse events, Incidence of anti-maridebart cafraglutide antibody formation including neutralizing antibodies against native glucagon-like peptide 1 (GLP-1), Change from baseline to week 24 in high-sensitivity C-reactive protein (hs-CRP)

Source: https://euclinicaltrials.eu/ctis-public/view/2024-513539-25-00